EU clinical trial 2026-526343-35-00: A double-blind, randomised, placebo-controlled first-in-human/Phase Ib trial to investigate safety, tolerability, pharmacokinetics, and preliminary efficacy of single and multiple doses of TIR-C 2% cutaneous emulsion in adults with mild to moderate atopic dermatitis
Protocol code: TIR-CT-001
Sponsor: Pharmability AB (Pharmaceutical company). Phase: Human Pharmacology (Phase I)- First administration to humans. Countries: Sweden (authorised, recruitment pending).
Therapeutic area(s): Diseases [C] - Skin and Connective Tissue Diseases [C17]
Gender: Female, Male. Age: 18-64 years, 65+ years. Enrolment: 52.
Status: Authorised, recruitment pending. Decision date: 2026-07-16. Results received: No. Last updated: 2026-07-16.

Condition(s): Atopic dermatitis

Source: https://euclinicaltrials.eu/ctis-public/view/2026-526343-35-00